EU clinical trial 2024-517270-23-00: "Diagnostic value of 68Ga-FAPI-46 PET/CT in the initial work-up of pancreatic and biliary cancers eligible to a curative treatment" "FAPDIG"
Protocol code: CHUBX 2022/39
Sponsor: Centre Hospitalier Universitaire De Bordeaux (Hospital/Clinic/Other health care facility). Phase: Therapeutic exploratory (Phase II). Countries: France (ongoing, recruiting).
Therapeutic area(s): Diseases [C] - Neoplasms [C04]
Gender: Female, Male. Age: 18-64 years, 65+ years. Enrolment: 120.
Status: Ongoing, recruiting. Start date (EU): 2026-03-05. Decision date: 2025-07-30. Results received: No. Last updated: 2026-05-27.

Condition(s): Cholangiocarcinoma, Pancreatic adenocarcinoma
Product: 68GA-FAPI-46, GalliaPharm, 0,74 à 1,85 GBq, générateur radiopharmaceutique, Galliad, 0,74 à 1,85 GBq, générateur radiopharmaceutique

Primary endpoint: Proportion of patients who present an appropriate change of TNM classification determined by initial staging, following the addition of 68Ga-FAPI-46 PET-CT
Endpoint(s): Proportion of patients who present an appropriate change of the M status of the TNM, determined by standard staging, following the addition of 68Ga-FAPI-46 PET-CT to the reference examinations, Proportion of patients who present an appropriate addition or removal of one of the following elements of therapeutic management : curative surgical treatment, neoadjuvant or adjuvant treatment by chemotherapy or radiotherapy, complementary surgical resection, palliative treatment by chemotherapy or other systemic treatment, following the addition of 68Ga-FAPI-46 PET-CT, Average number of tumor lesions, lymph node or distant, detected by 68Ga-FAPI-46 PET-CT compared to the number of tumor lesions detected by reference staging., Cohen's kappa coefficient measuring the inter-observer reliability of 68Ga-FAPI-46 PET/CT interpretation between coordinating center and investigating center observers, Diagnostic parameters (Sensitivity, Specificity, positive (VPP) and negative (VPN) predictive values) of 68Ga-FAPI-46 PET-CT for detection of loco-regional lymph node and distant metastatic lesions

Source: https://euclinicaltrials.eu/ctis-public/view/2024-517270-23-00